EU clinical trial 2024-518191-31-00: Vaccination against respiratory syncytial virus in patients with inflammatory rheumatic diseases. The impact of anti-rheumatic treatments on the RSV immune response.
Protocol code: RSV-REUMA
Sponsor: Region Skane (Hospital/Clinic/Other health care facility). Phase: Therapeutic use (Phase IV). Countries: Sweden (authorised, recruitment pending).
Therapeutic area(s): Diseases [C] - Virus Diseases [C02]; Diseases [C] - Musculoskeletal Diseases [C05]
Gender: Female, Male. Age: 18-64 years, 65+ years. Enrolment: 180.
Status: Authorised, recruitment pending. Decision date: 2025-07-09. Results received: No. Last updated: 2025-07-09.

Condition(s): Inflammatory rheumatic disease
Product: Arexvy powder and suspension for suspension for injection Respiratory Syncytial Virus (RSV) vaccine (recombinant, adjuvanted), Abrysvo powder and solvent for solution for injection Respiratory syncytial virus vaccine (bivalent, recombinant)

Primary endpoint: Antibody response, i.e. fold-change of RSVpreF-specific IgG antibody level from pre- to post-vaccination (3-6 weeks).
Endpoint(s): Functional RSVpreF-antigen specific T-cell response., Reported adverse events.

Source: https://euclinicaltrials.eu/ctis-public/view/2024-518191-31-00